EU clinical trial 2024-519113-59-00: NEOADJUVANT ATEZOLIZUMAB AND ADJUVANT ATEZOLIZUMAB + BEVACIZUMAB IN COMBINATION WITH PERCUTANEOUS RADIOFREQUENCY ABLATION OF SMALL HCC: A MULTICENTER RANDOMIZED PHASE II TRIAL
Sponsor: Centre Hospitalier Universitaire De Montpellier (Hospital/Clinic/Other health care facility). Phase: Therapeutic exploratory (Phase II). Countries: France (authorised, recruiting).
Therapeutic area(s): Diseases [C] - Neoplasms [C04]
Gender: Female, Male. Age: 18-64 years, 65+ years. Enrolment: 202.
Status: Authorised, recruiting. Start date (EU): 2024-11-20. Decision date: 2024-11-20. Results received: No. Last updated: 2024-11-20.

Condition(s): Hepatocellular carcinoma
Product: BEVACIZUMAB, ATEZOLIZUMAB

Primary endpoint: Recurrence-free survival: Recurrence is defined as recurrence or death, whichever comes first. Recurrence is defined as emergence of ≥ 1cm nodules enhanced at arterial phase followed by washout at portal or late phase observed on MRI, or any atypical nodule on imaging with histological features of HCC (EASL guidelines). Emergence of extrahepatic metastasis is also considered as a recurrence. Patients will be followed by MRI, 3, 6, 9, 12, 15, 18, 21and 24 months after randomization

Source: https://euclinicaltrials.eu/ctis-public/view/2024-519113-59-00